EU clinical trial 2024-513472-18-00: A study to test how insulin NNC0471-0119 H works in the body in participants with type 1 diabetes when given by an insulin pump.
Protocol code: NN1471-7712
Sponsor: Novo Nordisk A/S (Pharmaceutical company). Phase: Human Pharmacology (Phase I)- Other. Countries: Germany (ended).
Therapeutic area(s): Diseases [C] - Nutritional and Metabolic Diseases [C18]
Gender: Female, Male. Age: 18-64 years. Enrolment: 43.
Status: Ended. Start date (EU): 2025-01-23. End date (EU): 2025-07-28. Decision date: 2024-11-27. Results received: No. Last updated: 2025-06-24.
Decision dates by country: DE: 2025-01-03

Condition(s): Diabetes mellitus type 1

Source: https://euclinicaltrials.eu/ctis-public/view/2024-513472-18-00